EU clinical trial 2024-518553-41-00: PRODIGE 49 - OSCAR: Systemic oxaliplatin or in intra-arterial chemotherapy combined with LV5FU2 ± Irinotecan, and targeted therapy, in first-line treatment of metastatic colorectal cancer restricted to the liver
Protocol code: PRODIGE 49 -OSCAR
Sponsor: Fondation Franc.Cancerologie Digestive (Hospital/Clinic/Other health care facility). Phase: Therapeutic confirmatory (Phase III). Countries: France (ongoing, recruitment ended), Belgium (ongoing, recruitment ended).
Therapeutic area(s): Diseases [C] - Neoplasms [C04]
Gender: Female, Male. Age: 18-64 years, 65+ years. Enrolment: 348.
Status: Ongoing, recruitment ended. Start date (EU): 2024-11-08. Decision date: 2024-11-08. Results received: No. Last updated: 2025-12-16.
Decision dates by country: BE: 2024-11-08, FR: 2024-11-08

Condition(s): colon cancer and rectal with liver metastasis
Product: ELOXATINE 5 mg/ml, solution à diluer pour perfusion, ELOXATINE 5 mg/ml, solution à diluer pour perfusion

Primary endpoint: Comparison of radiological and/or clinical progression free survival between intra-arterial administration of oxaliplatin (arms A and C) and intravenous administration of oxaliplatin (arms B and D). Progression was assessed according to the criteria RECIST v1.1 and according to the investigator.
Endpoint(s): The adverse events will be graded according to NCI CTCAE v4.0 before each chemotherapy cycle., The best response under treatment will be evaluated based on the response RECIST v1.1 according to the investigator to the different Xrays; it will be described by the levels in the different categories: complete or partial response, stability, progression or non-evaluable., Overall survival: defined by the time between the date of treatment beginning and the date of death, whatever the cause; patients alive will be censured at the date of latest news., Hepatic progression free survival: defined by the time between the date of treatment beginning and the date of first hepatic progression or death, whatever the cause; patients alive without progression will be censured at the date of latest news., Early tumour shrinkage (difference > 20%) at 8 weeks: defined as the relative difference between the sum of the largest diameters of the RECIST target lesions at 8 weeks and this sum at inclusion (prior to C1 before randomization)., Depth of response: defined as the relative difference between the sum of the largest diameters of the RECIST target lesions in the NADIR (in the absence of new lesions or progression of non-target lesions) and the sum of the largest diameters of the RECIST target lesions at inclusion., Secondary resection rate: Rate of patients who were able to benefit from a resection of their tumor (primary and/or secondary) after treatment (by mentioning the character R0, R1 or R2), Evaluation of the histological response, TRG (Rubbia-Brandt L et al. Annals Oncol 2007) in case of hepatic resection, Evolution of the marker during treatment, Quality of life, Progression free survival under 'active' treatment defined by the time between the date of treatment beginning and the date of first progression under treatment (excluding therapeutic break) or death, whatever the cause; patients alive without progression will be censured at the date of latest news.

Source: https://euclinicaltrials.eu/ctis-public/view/2024-518553-41-00